EU clinical trial 2024-515551-38-00: Phase I study evaluating the safety and efficacy of MEDI5752 in combination with stereotactic radiotherapy in patients with metastatic sarcoma
Protocol code: 21 SARC 04
Sponsor: Oncopole Claudius Regaud (Hospital/Clinic/Other health care facility). Phase: Human Pharmacology (Phase I)- Other. Countries: France (ongoing, recruitment ended).
Therapeutic area(s): Diseases [C] - Neoplasms [C04]
Gender: Female, Male. Age: 18-64 years, 65+ years. Enrolment: 20.
Status: Ongoing, recruitment ended. Start date (EU): 2023-12-12. Decision date: 2024-08-09. Results received: No. Last updated: 2025-10-07.

Condition(s): Metastatic soft tissue sarcoma

Source: https://euclinicaltrials.eu/ctis-public/view/2024-515551-38-00